EU clinical trial 2023-509390-23-00: A Multicenter, Open-label, Phase 1/2, Dose-escalation and Subsequent Safety Extension Study of Subcutaneous KK8123 in Adult Patients with X-linked Hypophosphatemia
Protocol code: 8123-001
Sponsor: Kyowa Kirin Inc. (Pharmaceutical company). Phase: Human Pharmacology (Phase I)- First administration to humans. Countries: Germany (ongoing, recruiting), Spain (ongoing, recruiting), France (ongoing, recruiting).
Therapeutic area(s): Diseases [C] - Nutritional and Metabolic Diseases [C18]
Gender: Female, Male. Age: 18-64 years. Enrolment: 12.
Status: Ongoing, recruiting. Start date (EU): 2025-08-29. Decision date: 2024-11-11. Results received: No. Last updated: 2026-07-15.
Decision dates by country: FR: 2024-11-15, DE: 2024-11-12, ES: 2024-11-11

Condition(s): X-linked hypophosphatemia.
Product: KK8123

Primary endpoint: TEAEs., Laboratory values, Vital signs., 12-lead electrocardiogram., Echocardiogram., Renal ultrasound., Serum KK8123 concentrations over time and PK parameters.
Endpoint(s): Change in serum phosphorus levels over time., Change from baseline in serum phosphorus levels., Achieving serum phosphorus levels within the normal range through the last dosing interval., Achieving average serum phosphorus levels within the normal range across all dosing intervals., Incidence of anti-drug antibodies over time.

Source: https://euclinicaltrials.eu/ctis-public/view/2023-509390-23-00